EU clinical trial 2024-519614-30-00: A study in healthy people or otherwise healthy with overweight or obesity to compare 2 formulations of survodutide given in different ways, either as a pre-filled syringe or a pen-like injector
Protocol code: 1404-0015
Sponsor: Boehringer Ingelheim International GmbH (Pharmaceutical company). Phase: Human Pharmacology (Phase I)- Other. Countries: Germany (ended).
Therapeutic area(s): Not possible to specify
Gender: Female, Male. Age: 18-64 years. Enrolment: 56.
Status: Ended. Start date (EU): 2026-03-02. End date (EU): 2026-06-11. Decision date: 2026-01-28. Results received: No. Last updated: 2026-01-28.

Condition(s): Healthy volunteer trial

Source: https://euclinicaltrials.eu/ctis-public/view/2024-519614-30-00